EU clinical trial 2022-502057-33-00: A study to investigate safety and efficacy with SAR445514 in participants with relapsed/refractory multiple myeloma (RRMM) and relapsed/refractory light-chain amyloidosis (RRLCA)
Protocol code: TCD17710
Sponsor: Sanofi-Aventis Recherche & Developpement (Pharmaceutical company). Phase: Phase I and Phase II (Integrated)- First administration to humans. Countries: Hungary (ended), Belgium (ended), Spain (ended), Czechia (ended), Italy (ended), Greece (ended).
Therapeutic area(s): Diseases [C] - Neoplasms [C04]
Gender: Female, Male. Age: 18-64 years, 65+ years. Enrolment: 59.
Status: Ended. Start date (EU): 2023-10-02. End date (EU): 2025-05-26. End date: 2025-05-27. Decision date: 2023-06-15. Results received: No. Last updated: 2025-05-21.
Decision dates by country: ES: 2023-07-11, BE: 2023-06-20, CZ: 2023-09-26, IT: 2023-09-21, HU: 2023-06-21, GR: 2024-01-12

Condition(s): Relapsed/refractory multiple myeloma, Amyloid light-chain amyloidosis

Source: https://euclinicaltrials.eu/ctis-public/view/2022-502057-33-00